EU clinical trial 2024-517979-20-00: A Phase I/II, multi-site, open-label, two-part trial to evaluate the efficacy, safety, and pharmacokinetics of BNT323 in combination with BNT327 in participants with advanced breast cancer
Protocol code: BNT323-03
Sponsor: BioNTech SE (Pharmaceutical company). Phase: Phase I and Phase II (Integrated)- Other. Countries: Italy (ongoing, recruiting), Spain (ongoing, recruiting), France (ongoing, recruiting).
Therapeutic area(s): Diseases [C] - Neoplasms [C04]
Gender: Female, Male. Age: 18-64 years, 65+ years. Enrolment: 95.
Status: Ongoing, recruiting. Start date (EU): 2026-03-04. Decision date: 2025-11-11. Results received: No. Last updated: 2026-06-23.
Decision dates by country: IT: 2025-11-11, ES: 2025-11-17, FR: 2025-11-14

Condition(s): Advanced Breast Cancer Metastatic Breast Cancer
Product: BNT327, BNT323

Primary endpoint: Part 1 - Occurrence of dose limiting toxicities (DLTs) during the DLT evaluation period (Cycle 1), by dose level., Occurrence of Treatment-emergent adverse events (TEAEs), Grade greater than or equal to 3 TEAEs, serious adverse events (SAEs), treatment-related TEAEs, treatment-related Grade greater than or equal to 3 TEAEs, and treatment-related SAEs. In Part 1 by dose level. In Part 2 by cohort and arm., Occurrence of dose interruption, reduction, and discontinuation due to TEAEs In Part 1 by dose level. In Part 2 by cohort and arm., Part 2 - Objective response rate (ORR) defined as the proportion of participants in whom a confirmed complete response (CR) or partial response (PR) is observed as best overall response, by cohort and arm.
Endpoint(s): Part 1 - ORR defined as the proportion of participants in whom a confirmed CR or PR is observed as best overall response, by dose level., Part 2 - Duration of response (DoR) defined as the time from first objective response to first occurrence of objective tumor progression or death from any cause, whichever occurs first, by cohort and arm., Part 2 - Disease control rate (DCR) defined as the proportion of participants with confirmed CR, PR, or stable disease as best overall response, by cohort and arm., Part 2 - Time to response (TTR) defined as the time from first dose of IMP to first objective response, by cohort and arm., Part 2 Cohort 1 only - Progression free survival (PFS) based on the investigator’s assessment defined as the time from first dose of IMP to the first objective tumor progression or death from any cause, whichever occurs first, by arm.

Source: https://euclinicaltrials.eu/ctis-public/view/2024-517979-20-00